EU clinical trial 2023-509394-23-00: Adjuvant nivolumab treatment in stage II high-risk melanoma – A randomized, controlled, phase III trial with biomarker-based risk stratification (NivoMela)
Protocol code: CA209-7DL
Sponsor: Universitaetsklinikum Essen AöR (Hospital/Clinic/Other health care facility). Phase: Therapeutic confirmatory (Phase III). Countries: Germany (ongoing, recruitment ended).
Therapeutic area(s): Diseases [C] - Neoplasms [C04]
Gender: Female, Male. Age: 18-64 years, 65+ years. Enrolment: 423.
Status: Ongoing, recruitment ended. Start date (EU): 2020-06-12. Decision date: 2024-08-12. Results received: No. Last updated: 2026-03-06.

Condition(s): Stage II melanoma arising from a primary cutaneous site after surgery therapy
Product: OPDIVO 10 mg/mL concentrate for solution for infusion.

Primary endpoint: Relapse / Recurrence-free survival (RFS) will be analyzed by stratified Cox regression. RFS is defined as the time from the date of registration until documented tumor recurrence date or date of death of any cause, whichever occurs first.
Endpoint(s): RFS rate, Distant metastasis-free survival (DMFS) rate, Melanoma-specific survival (MSS) rate, Overall survival (OS) rate, AEs and clinical laboratory values, Clinical utility of the MelaGenix GEP score

Source: https://euclinicaltrials.eu/ctis-public/view/2023-509394-23-00